EU clinical trial 2025-524282-24-00: A Phase 3b, Open-Label Study of Crinecerfont to Evaluate Androgen Reduction and Related Outcomes in Adults With Classic Congenital Adrenal Hyperplasia
Protocol code: NBI-74788-CAH3033
Sponsor: Neurocrine Biosciences Inc. (Pharmaceutical company). Phase: Therapeutic confirmatory (Phase III). Countries: Czechia (authorised, recruitment pending), Germany (authorised, recruitment pending), Sweden (authorised, recruitment pending), Portugal (authorised, recruitment pending), Romania (authorised, recruitment pending), Bulgaria (authorised, recruitment pending), Italy (authorised, recruitment pending), Austria (authorised, recruitment pending), Spain (authorised, recruitment pending).
Therapeutic area(s): Diseases [C] - Hormonal diseases [C19]
Gender: Female, Male. Age: 18-64 years. Enrolment: 71.
Status: Authorised, recruitment pending. Decision date: 2026-07-23. Results received: No. Last updated: 2026-08-03.
Decision dates by country: DE: 2026-07-24, IT: 2026-07-24, RO: 2026-08-03, ES: 2026-07-25, SE: 2026-07-23, AT: 2026-07-27, BG: 2026-07-29, CZ: 2026-07-23, PT: 2026-07-24

Condition(s): Classic Congenital Adrenal Hyperplasia (CAH)
Product: NBI-74788

Primary endpoint: Change from baseline in pre-GC serum androstenedione at Week 24.

Source: https://euclinicaltrials.eu/ctis-public/view/2025-524282-24-00